EU clinical trial 2023-505684-36-00: A Study to Evaluate the Safety and Tolerability of JNJ-77730614 When Given as Single and Multiple Doses to Healthy Participants to Assess How Long JNJ 77730614 Stays in the Body (Pharmacokinetics) and How the Body Responds to it (Pharmacodynamics)
Sponsor: Janssen - Cilag International (Pharmaceutical company). Phase: Human Pharmacology (Phase I)- First administration to humans. Countries: Belgium (ended).
Therapeutic area(s): Diseases [C] - Immune System Diseases [C20]
Gender: Female, Male. Age: 18-64 years. Enrolment: 92.
Status: Ended. Start date (EU): 2023-10-09. End date (EU): 2024-06-28. Decision date: 2023-09-29. Results received: No. Last updated: 2024-02-22.

Condition(s): Healthy Volunteers

Source: https://euclinicaltrials.eu/ctis-public/view/2023-505684-36-00